EU clinical trial 2024-519444-33-00: A Phase 3, Multicenter, Randomized, Open-label Trial of Trastuzumab Deruxtecan Versus Standard of Care Chemotherapy With or Without Radiotherapy as Adjuvant Treatment for HER2-Expressing (IHC 3+/2+) Endometrial Cancer (DESTINY-Endometrial02/ GOG-3122/ ENGOT-en30/GINECO)
Protocol code: DS8201-854
Sponsor: Daiichi Sankyo Inc. (Pharmaceutical company). Phase: Therapeutic confirmatory (Phase III). Countries: Germany (authorised, recruitment pending), Poland (authorised, recruitment pending), France (ongoing, recruiting), Greece (ongoing, recruiting), Spain (ongoing, recruiting), Portugal (ongoing, recruiting), Italy (ongoing, recruiting).
Therapeutic area(s): Diseases [C] - Neoplasms [C04]
Gender: Female. Age: 18-64 years, 65+ years. Enrolment: 200.
Start date (EU): 2026-03-12. Decision date: 2025-12-11. Results received: No. Last updated: 2026-06-12.
Decision dates by country: GR: 2025-12-11, IT: 2025-12-11, PT: 2025-12-15, DE: 2025-12-12, PL: 2025-12-14, ES: 2025-12-12, FR: 2025-12-15

Condition(s): HER2-expressing endometrial cancer (IHC 3+/2+)
Product: Cisplatin Hikma 1 mg/ml Konzentrat zur Herstellung einer Infusionslösung, Carboplatin Hikma 10 mg/ml Konzentrat zur Herstellung einer Infusionslösung, Paclitaxel Ribosepharm 6 mg/ml Konzentrat zur Herstellung einer Infusionslösung, Docetaxel AqVida 20 mg/ml Konzentrat zur Herstellung einer Infusionslösung, DS-8201a

Primary endpoint: DFS is defined as time interval from the date of randomization to the first documented local-regional recurrence, distant metastasis, or death due to any cause, whichever occurs first. DFS will be assessed radiographically by BICR or by histopathologic confirmation of disease recurrence per local assessment.
Endpoint(s): OS is defined as the time interval from the date of randomization to the date of death due to any cause., DFS is defined as the time from randomization to the first documented local-regional recurrence, distant metastasis or death due to any cause, whichever occurs first. DFS will be assessed radiographically by investigator or by histopathologic confirmation of disease recurrence per local assessment., Distant metastatic recurrence is defined as recurrence outside of vagina, pelvis, or pelvic lymph nodes., Local recurrence is defined as recurrence in the vagina as assessed radiologically by BICR or by histopathologic confirmation of disease recurrence per local assessment, Regional recurrence is defined as recurrence in the pelvis or pelvic lymph nodes as assessed radiologically by BICR or by histopathologic confirmation of disease recurrence per local assessment, Incidence of TEAEs, SAEs, TEAEs associated with dose modifications, AESIs, TEAEs with death outcome, and changes from baseline in vital signs, clinical laboratory results, ECGs, ECHO/MUGA, and ophthalmologic assessments, Change from baseline and time to deterioration for the following PRO questionnaire: EORTC QLQ-C30 GHS/overall QoL, physical, Change from baseline and time to deterioration for the following PRO questionnaires: EORTC QLQ-EN24: Back and pelvic pain (ENBP), tingling/numbness (ENTN), muscular pain (ENM), Serum concentrations of T-DXd, total anti-HER2 antibody and DXd., ADA incidence: The proportion of participants having treatment-emergent ADA. Titer and nAb may be determined when ADA is positive.

Source: https://euclinicaltrials.eu/ctis-public/view/2024-519444-33-00